EU clinical trial 2022-500792-31-00: The effect of cabergoline in infertile women on peritoneal endometriosis related dysmenorrhea, chronic pelvic pain and fertility
Sponsor: Turku University Central Hospital (Hospital/Clinic/Other health care facility). Phase: Therapeutic use (Phase IV). Countries: Finland (not authorised).
Therapeutic area(s): Diseases [C] - Female Urogenital Diseases and Pregnancy Complications [C13]
Gender: Female. Age: 18-64 years. Enrolment: 80.
Status: Not authorised. Decision date: 2022-12-22. Results received: No. Last updated: 2022-12-22.

Condition(s): Endometriosis in women with involuntary infertility
Product: Lume-kapselissa puolitettu yliopiston apteekin Placebo 9 mm tabletti (sis. mikrokiteistä selluloosaa sekä magnesium stearaattia)., Dostinex 0,5 mg tablett

Primary endpoint: The worst Numeric Rating Scale of menstrual pain, weekly pelvic pain and pain during intercourse at baseline, during the treatment, at the end of treatment and at follow up after three natural or ovulation induction cycles and the change of worst NRS at baseline, at the end of treatment and at follow up after three natural or ovulation induction cycles. The number of subjects with reduction of the worst NRS of menstrual pain, weekly pelvic pain and weekly pain during intercourse by ≥30%, ≥50% ja

Source: https://euclinicaltrials.eu/ctis-public/view/2022-500792-31-00